EU clinical trial 2024-516715-25-00: Intraglandular treatment with adipose derived mesenchymal stem cells in patients with xerostomia due to Sjögrens syndrome (ASSIX)
Sponsor: Rigshospitalet (Hospital/Clinic/Other health care facility). Phase: Phase I and Phase II (Integrated)- Other. Countries: Denmark (ongoing, recruiting).
Therapeutic area(s): Analytical, Diagnostic and Therapeutic Techniques and Equipment [E] - Therapeutics [E02]
Gender: Female, Male. Age: 18-64 years, 65+ years. Enrolment: 40.
Status: Ongoing, recruiting. Start date (EU): 2025-01-21. Decision date: 2024-10-21. Results received: No. Last updated: 2024-10-21.

Condition(s): Sjögrens Syndrone
Product: CL-AD-MSC-002, Placebo consists of sterile isotonic saline water 0,9%.

Primary endpoint: The primary objective of this study is to investigate the effectiveness of injection of adipose derived mesenchymal stem cells in the submandibular glands compared to injection of placebo on the salivary gland function measured as the change in the unstimulated whole saliva flow rate (UFR) from baseline to 4 months after treatment in patients with orimary Sjögren Syndrome related xerostomia.

Source: https://euclinicaltrials.eu/ctis-public/view/2024-516715-25-00